EU clinical trial 2024-517580-23-00: Phase I, open-label study to evaluate the safety and immune activity of PeptiCRAd-1, an oncolytic virus coated with tumor-specific peptides in combination with the immunotherapy drug pembrolizumab in patients with injectable solid tumors in defined indications
Protocol code: VALO-001
Sponsor: Valo Therapeutics Oy (Pharmaceutical company). Phase: Human Pharmacology (Phase I)- First administration to humans. Countries: Germany (ongoing, recruitment ended), Italy (ongoing, recruiting).
Therapeutic area(s): Diseases [C] - Neoplasms [C04]
Gender: Female, Male. Age: 18-64 years, 65+ years. Enrolment: 23.
Start date (EU): 2023-03-07. Decision date: 2024-11-08. Results received: No. Last updated: 2026-07-31.
Decision dates by country: DE: 2024-11-08, IT: 2025-10-24

Condition(s): Colorectal cancer, Triple negative breast cancer, Non-small cell lung cancer, Sarcoma, Melanoma

Source: https://euclinicaltrials.eu/ctis-public/view/2024-517580-23-00